EU clinical trial 2025-520545-74-00: Venetoclax as treatment of acute graft-versus-host disease in patients after allogeneic hematopoietic stem cell transplantation in a Phase-II dose escalation pilot study.
Protocol code: Venetoclax-aGVHD
Sponsor: Medical University Of Vienna (Educational Institution). Phase: Therapeutic exploratory (Phase II). Countries: Austria (authorised, recruiting).
Therapeutic area(s): Diseases [C] - Immune System Diseases [C20]
Gender: Female, Male. Age: 18-64 years, 65+ years. Enrolment: 24.
Status: Authorised, recruiting. Start date (EU): 2026-06-24. Decision date: 2025-11-10. Results received: No. Last updated: 2026-03-13.

Condition(s): Acute graft-versus-host disease of the skin
Product: Venclyxto 100 mg film-coated tablets, Venclyxto 10 mg film-coated tablets, Venclyxto 50 mg film-coated tablets

Primary endpoint: Definition of the Maximum Tolerated Dose (MTD) after 28 and 56 days (Phase 1)
Endpoint(s): Safety of Venetoclax in aGVHD after 28 and 56 days, Remission rate of aGVHD and rate of progression to SR-aGVHD upon Venetoclax, Non-relapse mortality and overall survival after Venetoclax in aGVHD, Effects of Venetoclax on aGVHD-causing effector cells in peripheral blood and affected tissue, Hematologic grade IV toxicities and Grade III/IV non-hematologic toxicities graded according to the NCI CTCAE criteria CTCAE version 4.03., Efficacy of venetoclax, Inhibition of BCL2 pathway by venetoclax in peripheral blood and the skin on a single cell level, Immunological signature(s) by genome, epigenome and transcriptome sequencing, Baseline BCL2 activity identifying patients as responders or enabling monitoring of response to venetoclax by flow cytometry and immunofluorescence, Quality of life questionnaire, fatigue scale

Source: https://euclinicaltrials.eu/ctis-public/view/2025-520545-74-00